EU clinical trial 2024-519277-18-00: A study investigating the safety of RO7795081 and the effect of RO7795081 on how the body processes different approved medications. RO7795081 is a new compound that may potentially be used in the treatment of type 2 diabetes and weight control
Protocol code: BP45800
Sponsor: F. Hoffmann-La Roche AG (Pharmaceutical company). Phase: Human Pharmacology (Phase I)- Other. Countries: Netherlands (ongoing, recruiting).
Therapeutic area(s): Diseases [C] - Nutritional and Metabolic Diseases [C18]
Gender: Female, Male. Age: 18-64 years. Enrolment: 40.
Status: Ongoing, recruiting. Start date (EU): 2025-05-08. Decision date: 2025-04-17. Results received: No. Last updated: 2026-05-21.

Condition(s): Obesity or Overweight

Source: https://euclinicaltrials.eu/ctis-public/view/2024-519277-18-00